EU clinical trial 2024-514606-31-00: LENVABLA Lenvatinib in neo-adjuvant and adjuvant therapy for poor-prognosis BCLC A HepatoCellular Carcinoma treated by percutaneous ablation procedure in a curative intent: multicentre pilot therapeutic trial
Protocol code: APHP201185
Sponsor: Assistance Publique Hopitaux De Paris (Hospital/Clinic/Other health care facility). Phase: Therapeutic exploratory (Phase II). Countries: France (ongoing, recruiting).
Therapeutic area(s): Not possible to specify
Gender: Female, Male. Age: 18-64 years, 65+ years. Enrolment: 50.
Status: Ongoing, recruiting. Start date (EU): 2024-10-29. Decision date: 2024-10-29. Results received: No. Last updated: 2026-04-30.

Condition(s): Patients with Biopsy-proven or radiologically-suggested BCLC A HCC eligible for PA and comprising at least one of the following criteria: - Single tumour>3 cm≤ 5cm or - multiple tumours (max 3 lesions ≤ 3cm) or - Single tumour between 2 and 3 cm with at least one of the following characteristic: • Serum AFP>100 ng/mL; • Infiltrative form; • Macro-trabecular subtype (if applicable)
Product: LENVIMA 4 mg hard capsules

Primary endpoint: One-year local recurrence-free survival (potentially compared with historical controls, see references)
Endpoint(s): - Per nodule assessment of early response (one month) after PA, - Per nodule assessment of local recurrence, - Per nodule assessment of intra segmental distant recurrence, - Per nodule assessment of extra segmental distant recurrence, - Assessment of overall recurrence-free survival at 1 and 2 years, - Evaluation of the safety of lenvatinib administered as neo and adjuvant therapy, - Study of tumour and non-tumour histological/molecular predictors of therapeutic response and resistance based on sequential biopsies performed before and after neo-adjuvant phase then in case of recurrence (if applicable)., - Compliance to lenvatinib treatment, - Consittution of a sequential biobank comprising liver tissue (if applicable) and peripheral samples (serum, plasma)

Source: https://euclinicaltrials.eu/ctis-public/view/2024-514606-31-00